EU clinical trial 2024-514580-26-00: An open label, single-arm, phase 2 study of neoadjuvant PEMbrolizumab before radical PROstatectomy (PEM-PRO) in high-risk prostate cancer patients
Sponsor: Ospedale San Raffaele S.r.l. (Hospital/Clinic/Other health care facility). Phase: Therapeutic exploratory (Phase II). Countries: Italy (ended).
Therapeutic area(s): Diseases [C] - Male Urogenital Diseases [C12]
Gender: Male. Age: 18-64 years, 65+ years. Enrolment: 59.
Status: Ended. End date (EU): 2026-04-22. Decision date: 2024-10-08. Results received: No. Last updated: 2024-10-08.

Condition(s): High-risk prostate cancer
Product: KEYTRUDA 25 mg/mL concentrate for solution for infusion, [68GA]PSMA-HBED-CC

Primary endpoint: A reduction of 50% in the rate of node positive patients compared to what currently reported in the literature represents the main endpoint of the study (rate of pN0 of 85 vs. 70%)

Source: https://euclinicaltrials.eu/ctis-public/view/2024-514580-26-00